EU clinical trial 2025-522613-26-00: First-in-human, Open-label, Multi-site, Phase I/IIa, Dose Escalation Trial With Expansion Cohorts to Evaluate Safety and Preliminary Efficacy of BNT329 in Participants With Advanced Solid Tumors Known to Express CA19-9
Protocol code: BNT329-01
Sponsor: BioNTech SE (Pharmaceutical company). Phase: Phase I and Phase II (Integrated)- First administration to humans. Countries: Spain (ongoing, recruiting), Germany (ongoing, recruiting).
Therapeutic area(s): Diseases [C] - Neoplasms [C04]
Gender: Female, Male. Age: 18-64 years, 65+ years. Enrolment: 90.
Status: Ongoing, recruiting. Start date (EU): 2026-03-13. Decision date: 2026-01-29. Results received: No. Last updated: 2026-06-01.
Decision dates by country: DE: 2026-01-30, ES: 2026-01-29

Condition(s): Advanced Solid Cancers
Product: BNT329

Primary endpoint: Parts A, B, and C: Occurrence of dose-limiting toxicities (DLTs) within a participant per dose level/cohort., All parts: Occurrence of treatment-emergent adverse events (TEAEs), Grade ≥3 TEAEs, serious adverse events (SAEs), treatment-related TEAEs, treatment-related Grade ≥3 TEAEs, and treatment-related SAEs per dose level/cohort., All parts: Occurrence of dose interruptions, reductions, and discontinuation of BNT329 due to TEAEs per dose level/cohort., Part D: Objective response rate (ORR) per dose level/arm. Defined as the proportion of participants in whom a confirmed complete response (CR) or partial response (PR) (based on the investigator’s assessment) is observed as best overall response.
Endpoint(s): All parts: Assessment of PK parameters derived from serum concentrations of CA19-9-unbound ADC, CA19-9-unbound total anti-CA19-9 antibody, and unconjugated YL0010014 payload per dose level/cohort. Assessment of area under the curve, maximum concentration, time to reach maximum concentration, and terminal half-life, Parts A, B, and C: ORR per dose level/arm. Defined as the proportion of participants in whom a confirmed complete response (CR) or partial response (PR) (based on the investigator’s assessment) is observed as best overall response., All parts: Disease control rate (DCR) Per dose level/arm. Defined as as the proportion of participants in whom a CR or PR or SD (assessed at least 6 weeks is observed as best ORR per investigator’s assessment., All parts: Duration of response (DOR) Per dose level/arm. Defined as the time from first objective response (CR or PR) to first occurrence of objective tumor progression (PD) or death from any cause, whichever occurs first., All parts: Anti-drug antibody (ADA) prevalence per dose level/cohort. Defined as the proportion of participants who are ADA positive at any timepoint (either baseline or post-baseline) (if data permit)., All parts - ADA incidence per dose level/cohort. Defined as the proportion of participants having treatment-emergent ADA (if data permit).

Source: https://euclinicaltrials.eu/ctis-public/view/2025-522613-26-00